EU clinical trial 2023-505000-27-01: A phase II, single arm, open label, study on the safety, efficacy, pharmacokinetics and pharmacodynamics of quizartinib in combination with chemotherapy and as single-agent after high dose therapy in newly diagnosed pediatric FLT3-ITD positive and NPM1 wild-type AML patients (A linked-trial of the CHIP-AML22/Master protocol by the NOPHO-DB-SHIP consortium)
Protocol code: MH22CAQ
Sponsor: Prinses Maxima Centrum voor Kinderoncologie B.V. (Hospital/Clinic/Other health care facility). Phase: Therapeutic exploratory (Phase II). Countries: Netherlands (ongoing, recruiting), Belgium (authorised, recruiting), Estonia (authorised, recruiting), Iceland (authorised, recruiting), Latvia (authorised, recruiting), Lithuania (authorised, recruiting), Portugal (authorised, recruitment pending), Spain (ongoing, recruiting), Denmark (ongoing, recruiting), Norway (ongoing, recruiting), Finland (authorised, recruiting), Sweden (ongoing, recruiting).
Therapeutic area(s): Diseases [C] - Neoplasms [C04]
Gender: Female, Male. Age: 0-17 years, 18-64 years. Enrolment: 60.
Start date (EU): 2023-12-29. Decision date: 2023-12-27. Results received: No. Last updated: 2026-07-22.
Decision dates by country: NL: 2023-12-27, DK: 2025-06-16, SE: 2025-06-09, FI: 2025-06-13, NO: 2025-06-20, ES: 2024-07-30, IS: 2024-08-12, BE: 2024-10-14, EE: 2024-09-16, LT: 2024-09-13, LV: 2024-09-03, PT: 2024-09-06

Condition(s): newly diagnosed pediatric FLT3-ITD positive and NPM1 wild-type AML
Product: Quizartinib

Primary endpoint: Efficacy: The percentage of patients with MRD levels <0.1% (MRD negativity) after up to 2 courses of induction chemotherapy plus quizartinib, as measured in the bone marrow using multiparameter flow cytometry (MFCM) before start of consolidation therapy, in the evaluable population for response. o Patients to be evaluated at baseline, end of cycle 1, and end of cycle 2, Safety: Incidence of Dose-Limiting Toxicities (DLTs) assessed during Induction course 1 and 2 (until day 56 of each course) for the DLTs evaluable patients.
Endpoint(s): Efficacy: Other measurements of treatment response: o Proportion of subjects with a complete remission (CR) rate without evidence of MRD after 1 and after 2 induction courses (including CR and remission with incomplete blood count or platelet recovery), Efficacy: Other measurements of treatment response: o Bone marrow blast counts by morphology and MFCM after induction course 1 and induction course 2 and before allo-SCT; CRc (CR and CRi) and morphologic leukemia-free state (MLFS) rates after induction course 1 and 2; MRD negativity (<0.1%), after course 1 and 2 and before allo-HSCT; Absolute MRD levels after induction course 1 and 2, and before allo-HSCT;, Efficacy: Other measurements of treatment response: o Bone marrow blast counts by morphology and MFCM at other timepoints (The disease assessments at other time-points (e.g., After consolidation course 2, 3, before/during continuation treatment), Efficacy: Other measurements of treatment response: o Event-free survival (EFS) probability, at least at 1, 2 and 3 years Time from the start of treatment until an event, defined as 1) not achieving CR/CRi because of early death or with refractory disease (ie: treatment failure); 2) morphological relapse; 3) second malignancy; 4) death in complete remission due to any cause., Efficacy: Other measurements of treatment response: o Overall survival (OS) probability, at least at 1, 2 and 3 years. o Time from the start of treatment until death, due to any cause., Efficacy: Other measurements of treatment response: o Disease free survival (DFS) probability, at least at 1, 2 and 3 years. o Time from CR/CRi until morphological relapse or death due to any cause, Efficacy: Other measurements of treatment response: o Duration of complete response. o Time from CR until morphological relapse or death due to any cause, Efficacy: Other measurements of treatment response: o Cumulative incidence of morphological relapse (CIR) probability, at least at 1,2 and 3 years, Efficacy: Other measurements of treatment response: o Number and percentage of patients proceeding to HSCT, Efficacy: Other measurements of treatment response: o Number of patients starting and completing continuation treatment post-HSCT, Safety o Adverse events (AEs), as characterized by type, frequency, severity (as graded using CTCAE, v5.0)., Safety: o Laboratory abnormalities (including time to recovery of ANC and PLT), electrocardiograms and changes in vital signs as characterized by type, frequency, severity and timing will be tabulated, and reported as AEs when considered clinically significant by the investigator., Safety: The cumulative incidence of non-relapse mortality, defined as the cumulative probability of non-relapse mortality, with time calculated between start of study treatment and death due to other causes than relapsed or refractory leukemia, accounting for competing events., Pharmacokinetics (PK): Population PK analysis to estimate AUC (tau) and Cmax for quizartinib and AC886, clearance (CL/F) and volume of distribution (Vss/F) for quizartinib., Palatability: Patients and/or parents or legal guardians will answer using a Hedonic scale for the taste and ability to swallow the medicine.

Source: https://euclinicaltrials.eu/ctis-public/view/2023-505000-27-01